EU clinical trial 2024-513295-18-00: Pilot phase II study of Selinexor in combination with Ifosfamide, Etoposide and Dexamethasone (SIDE) in patients with relapsed or refractory Peripheral T-cell Lymphomas
Protocol code: PTCL S-IDE
Sponsor: Fondazione IRCCS Istituto Nazionale Dei Tumori (Hospital/Clinic/Other health care facility). Phase: Therapeutic exploratory (Phase II). Countries: Italy (ongoing, recruitment ended).
Therapeutic area(s): Diseases [C] - Hemic and Lymphatic Diseases [C15]
Gender: Female, Male. Age: 18-64 years, 65+ years. Enrolment: 30.
Status: Ongoing, recruitment ended. Start date (EU): 2022-08-10. Decision date: 2024-05-20. Results received: No. Last updated: 2026-05-29.

Condition(s): Relapsed or Refractory Peripheral T-cell Lymphomas
Product: ETOPOSIDE TEVA 20 mg/ml, concentrato per soluzione per infusione., HOLOXAN 1 g polvere per soluzione per infusione, NEXPOVIO 20 mg film-coated tablets, Decadron “8 mg/2 ml Soluzione iniettabile”

Primary endpoint: ORR at the end of 4 courses of S-IDE
Endpoint(s): DOR, 18-months PFS, 18-months OS, TRM, CR by histotypes, Proportion of patients able to undergo SCT, Adverse events (grading/onset/severity) according to SOC and within the CTCAE v.5.0 category

Source: https://euclinicaltrials.eu/ctis-public/view/2024-513295-18-00